EU clinical trial 2023-505036-35-00: A Multicenter, Parallel group, Double-blind, Placebo-controlled, Randomized, Efficacy and Safety Study of Nicotine Freshmint Mouthspray in E-cigarette Users Willing to Quit
Protocol code: CCSSMC005220
Sponsor: McNeil AB (Pharmaceutical company). Phase: Therapeutic confirmatory (Phase III). Countries: Germany (ended).
Therapeutic area(s): Diseases [C] - Pathological Conditions, Signs and Symptoms [C23]
Gender: Female, Male. Age: 18-64 years, 65+ years. Enrolment: 200.
Status: Ended. Start date (EU): 2024-04-23. End date (EU): 2025-12-22. End date: 2026-01-12. Decision date: 2024-01-09. Results received: No. Last updated: 2025-11-19.

Condition(s): Vaping cessation in e-cigarette users
Product: Nicorette Mint Spray 1 mg/Sprühstoß Spray zur Anwendung in der Mundhöhle, Lösung, Placebo mint mouthspray (identical in appearance and formulation, except it does not contain nicotine)

Primary endpoint: Continuous self-reported abstinence from e-cigarettes and CO-verified abstinence from conventional cigarettes from the visit at week 2 up to and including the visits at weeks 6, 30, and 52 respectively, with cotinine verification at visits weeks 30 and 52.
Endpoint(s): Continuous self-reported abstinence from e-cigarettes from the visit at week 2 up to and including the visits at weeks 4, 8, 12, 16, 20, and 26, respectively, with CO-verification of smoking abstinence at visits weeks 2, 4, 12, and 26., Point-prevalence 7-day abstinence from e-cigarettes at all post-baseline visits with COverification for smoking abstinence at all visits except for visits at weeks 8, 16, and 20 and with cotinine verification at visits weeks 30 and 52., Separate severity ratings of urge-to-vape and urge-to-smoke in the last 24 hours recorded in the CRFs at weeks 2, 4 and 6 visits. Severity ratings of individual and composite withdrawal symptom scores in the last 24 hours recorded in the CRFs at visits weeks 2, 4 and 6., Average daily number of trial product doses recorded in the CRFs at all post-baseline visits up to and including the visit at week 26., E-cigarette consumption recorded in the CRFs at all post-baseline visits., Separate urge-to-vape and urge-to-smoke severity in the last 24 hours recorded daily in a participant electronic diary (eDiary) from baseline up to the week 2 visit. E-cigarette consumption recorded daily in the eDiary from screening up to the week 2 visit., Safety will be monitored and assessed by reviewing the collection, evaluation, and analysis of participant-reported adverse events.

Source: https://euclinicaltrials.eu/ctis-public/view/2023-505036-35-00